EU clinical trial 2024-517498-25-00: A Phase 2, Double-Blind, Randomized, Placebo-Controlled, Multicenter Study to Evaluate Efficacy and Safety of ALXN2030 in Adult Patients with Antibody-Mediated Rejection after Kidney Transplantation
Protocol code: ALXN2030-AMR-201
Sponsor: Alexion Pharmaceuticals Inc. (Pharmaceutical company). Phase: Therapeutic exploratory (Phase II). Countries: Spain (ongoing, recruitment ended).
Therapeutic area(s): Diseases [C] - Pathological Conditions, Signs and Symptoms [C23]
Gender: Female, Male. Age: 18-64 years, 65+ years. Enrolment: 6.
Status: Ongoing, recruitment ended. Start date (EU): 2026-01-29. Decision date: 2025-10-28. Results received: No. Last updated: 2026-03-11.

Condition(s): Antibody-Mediated Rejection after Kidney Transplantation
Product: Vialed Saline Placebo, ALXN2030

Primary endpoint: Biopsy-proven histologic resolution at Week 52
Endpoint(s): Biopsy-proven histologic resolution at Week 28., Resolution of AMR activity at Weeks 28 and 52., Change from baseline in biopsy-proven histologic score at Weeks 28 and 52., eGFR change from baseline at Week 52., Annualized total eGFR slope during 52 weeks of treatment., Stabilized eGFR (annualized eGFR slope > -1) during 52 weeks of treatment., Incidence of TEAEs and TESAEs over time., ALXN2030 plasma concentration over time., Absolute values, change from Baseline and percent change from Baseline in plasma concentrations of C3 protein over time and in serum complement functional activity over time., Anti-ALXN2030 Ab incidence, category of ADA response, and titer through the duration of the study.

Source: https://euclinicaltrials.eu/ctis-public/view/2024-517498-25-00